EU clinical trial 2024-513502-62-00: A Study of Orally Administered MOMA-313 in Participants with Advanced or Metastatic Solid Tumours
Protocol code: MOMA-313-001
Sponsor: Moma Therapeutics Inc. (Pharmaceutical company). Phase: Human Pharmacology (Phase I)- First administration to humans. Countries: Spain (ongoing, recruiting).
Therapeutic area(s): Diseases [C] - Neoplasms [C04]
Gender: Female, Male. Age: 18-64 years, 65+ years. Enrolment: 48.
Status: Ongoing, recruiting. Start date (EU): 2025-03-07. Decision date: 2025-02-18. Results received: No. Last updated: 2026-01-23.

Condition(s): Advanced or Metastatic Solid Tumors

Source: https://euclinicaltrials.eu/ctis-public/view/2024-513502-62-00